EU clinical trial 2022-502401-15-00: A Study of NB003 in Patients With Advanced Malignancies
Protocol code: NB003-01
Sponsor: Ningbo Newbay Technology Development Co. Ltd. (Hospital/Clinic/Other health care facility). Phase: Phase I and Phase II (Integrated)- First administration to humans. Countries: Spain (ended), France (ended).
Therapeutic area(s): Diseases [C] - Neoplasms [C04]
Gender: Female, Male. Age: 18-64 years, 65+ years. Enrolment: 37.
Status: Ended. Start date (EU): 2023-10-19. End date (EU): 2025-08-01. End date: 2025-08-01. Decision date: 2023-06-26. Results received: No. Last updated: 2025-07-31.
Decision dates by country: FR: 2023-06-26, ES: 2023-06-26

Condition(s): Gastrointestinal stromal tumor, Solid tumors, Melanoma

Source: https://euclinicaltrials.eu/ctis-public/view/2022-502401-15-00